EU clinical trial 2022-501398-38-00: CALIBRATE: A Phase 3, Randomized, Open-Label Study Evaluating the Efficacy and Safety of Encaleret Compared to Standard of Care in Participants with Autosomal Dominant Hypocalcemia Type 1 (ADH1)
Protocol code: CLTX-305-302
Sponsor: Calcilytix Therapeutics Inc. (Pharmaceutical company). Phase: Therapeutic confirmatory (Phase III). Countries: Belgium, France (ongoing, recruitment ended), Netherlands (ongoing, recruitment ended), Czechia (ongoing, recruitment ended), Denmark (ongoing, recruitment ended), Italy (ongoing, recruitment ended).
Therapeutic area(s): Diseases [C] - Nutritional and Metabolic Diseases [C18]
Gender: Female, Male. Age: 18-64 years, 65+ years. Enrolment: 34.
Start date (EU): 2023-09-02. Decision date: 2023-06-13. Results received: No. Last updated: 2026-06-17.
Decision dates by country: BE: 2023-06-13, CZ: 2023-06-21, NL: 2023-06-21, DK: 2023-06-13, FR: 2023-06-21, IT: 2023-06-21

Condition(s): Autosomal Dominant Hypocalcemia Type 1 (ADH1)
Product: COLECALCIFEROL, CALCIUM CARBONATE, Encaleret tablets (GEN2), Encaleret GEN1, Encaleret GEN1, Encaleret GEN1, ALFACALCIDOL, CALCITRIOL, CALCIUM ACETATE ANHYDROUS, Encaleret GEN1, ALFACALCIDOL, Encaleret tablets (GEN2), Encaleret tablets (GEN2), CALCITRIOL, Encaleret tablets (GEN2), Encaleret tablets (GEN2)

Primary endpoint: The primary efficacy endpoint is the responder status of each participant. (...)
Endpoint(s): 1. Key secondary endpoints are categorized into the following families: • Within -Patient Endpoint Family o iPTH status of each participant at each maintenance period. The positive result of this binary endpoint is defined as iPTH within or greater than the reference range at the completion of the maintenance period (Period 1 or 3), 2. Between-Treat. Endp. Family ° Responder status of each particip. (...) ° iPTH status of each particip. The positive result of this binary endp. is defined as iPTH within or greater than the ref. range at the compl. of the maint. period (Period 3), 3a. Additional secondary endpoints include: Observed cCa, 24-hr UCa, iPTH, blood phosphate, and blood magnesium values and changes from baseline over time, 3b. Additional secondary endpoints incl.: Responder status of each participant. (...), 3c. Additional secondary endpoints incl.: Blood phosphate status of each participant over time. The positive result of this binary endpoint is defined as blood phosphate within the reference range, 3d. Additional secondary endpoints incl.: Blood magnesium status of each participant over time. The positive result of this binary endpoint is defined as blood magnesium within the reference range., 3e. Additional secondary endpoints incl.: cCa and 24-hr UCa status of each participant. The positive result of this binary endpoint is defined as meeting both of the following criteria at the completion of the maintenance period (Period 1 or Period 3): (...), 3e. (cont.) (...), 3f. Additional secondary endpoint incl.: cCa and 24-hr UCa status without titration or supplemental calcium/vitamin D of each participant. The positive result of this binary endpoint is defined as meeting both of the following criteria at the completion of the maintenance period (Period 1 or Period 3): (...), 3f. (cont.) −(...) and both of the following criteria during the maintenance period (Period 1 or Period 3: − no titration of encaleret or SoC − no oral calcium > 600 mg/day and/or active vitamin D for the participants randomized to encaleret arm, 3g. Additional secondary endpoint incl.: Change from Baseline in 36-Item Short Form Health Survey (SF-36) physical component score and mental component score and each of the sub-domains to Week 24 (Period 3), 4. Change from Baseline in urine magnesium, phosphate, sodium, and citrate handling to Week 24 (Period 3), 5. Change from Baseline in QTcF as assessed by electrocardiogram (ECG) to Week 24 (Period 3), 6. Change from Baseline in 36-Item Short Form Health Survey (SF-36) physical component score and mental component score and each of the sub-domains to Week 24 (Period 3), 7. Adverse events (AEs) and serious adverse events (SAEs), including frequency and severity., 8. Changes from baseline for the following: o Vital signs o Physical examination o Renal ultrasound to evaluate nephrocalcinosis and nephrolithiasis o 12-lead ECG o Safety laboratory tests including chemistry, hematology, coagulation, and urinalysis, 9. Dose and frequency of calcium supplements and/or active Vitamin D analogue requirements for participants randomized to the encaleret treatment arm, 10. Determination of steady state encaleret trough concentration (Ctrough) during Periods 2 and 3

Source: https://euclinicaltrials.eu/ctis-public/view/2022-501398-38-00